EU clinical trial 2024-513053-69-00: A Phase III, Multicenter, Double-Blind, Placebo Controlled, Treat-Through Study to Assess the Efficacy and Safety of Induction and Maintenance Therapy with RO7790121 in Patients with Moderately to Severely Active Crohn's Disease
Protocol code: GA45331
Sponsor: F. Hoffmann-La Roche AG (Pharmaceutical company). Phase: Therapeutic confirmatory (Phase III). Countries: Italy (ongoing, recruiting), France (ongoing, recruiting), Belgium (ongoing, recruiting), Hungary (ongoing, recruiting), Denmark (ongoing, recruiting), Romania (ongoing, recruiting), Croatia (ongoing, recruiting), Bulgaria (ongoing, recruiting), Czechia (ongoing, recruiting), Portugal (ongoing, recruiting), Slovakia (ongoing, recruiting), Austria (ongoing, recruiting), Poland (ongoing, recruiting), Spain (ongoing, recruiting), Netherlands (ongoing, recruiting), Germany (ongoing, recruiting).
Therapeutic area(s): Diseases [C] - Digestive System Diseases [C06]
Gender: Female, Male. Age: 18-64 years, 65+ years. Enrolment: 348.
Status: Ongoing, recruiting. Start date (EU): 2025-04-16. Decision date: 2025-04-14. Results received: No. Last updated: 2026-03-24.
Decision dates by country: HU: 2025-04-16, PT: 2025-04-16, NL: 2025-04-17, DK: 2025-04-15, ES: 2025-04-14, HR: 2025-04-22, IT: 2025-04-15, DE: 2025-04-22, FR: 2025-04-14, PL: 2025-04-29, AT: 2025-04-22, BG: 2025-04-16, RO: 2025-04-22, CZ: 2025-04-15, BE: 2025-04-15, SK: 2025-04-14

Condition(s): Moderately to Severely Active Crohn's Disease (CD)
Product: RO7790121 Placebo, RO7790121

Primary endpoint: 1. Clinical remission, defined as CDAI < 150,, 2. Endoscopic response, defined as decrease in SES-CD from baseline ≥ 50%,
Endpoint(s): 1. Clinical remission, as defined above,, 2. Endoscopic response, as defined above,, 3. Symptomatic remission,, 4. Endoscopic remission,, 5. Ulcer-free endoscopy,, 6. SF, from baseline, 7. APS, from baseline, 8. Endoscopic remission,, 9. Symptomatic remission,, 10. Corticosteroid-free clinical remission,, 11. Maintenance of clinical remission,, 12. Maintenance of endoscopic response,, 13. Clinical remission and endoscopic remission,, 14. Ulcer-free endoscopy,, 15. Bowel urgency, from baseline, 16. Fatigue, as measured by Functional Assessment of Chronic Illness Therapy-Fatigue Scale (FACIT-F), from baseline, 17. Inflammatory Bowel Disease Questionnaire (IBDQ) score, from baseline, 18. Clinical remission, 19. Clinical remission, 20. Endoscopic response, 21. Endoscopic response, 22. Clinical response,, 23. Symptomatic response,, 24. Overall change in CD symptoms,, 25. Overall severity in CD symptoms,, 26. General well-being, from baseline, 27. Incidence and severity of the following: - Adverse events, 28. Incidence and severity of the following: - Serious adverse events, 29. Incidence and severity of the following: - Adverse events leading to study treatment discontinuation, 30. Incidence and severity of the following: - Adverse events of special interest, 31. Presence of draining fistulas

Source: https://euclinicaltrials.eu/ctis-public/view/2024-513053-69-00